EU clinical trial 2025-522471-28-00: A Phase 3, multicenter, open-label extension study to evaluate the long-term safety, tolerability, and efficacy of subcutaneous sonelokimab in participants with psoriatic arthritis (PsA)
Protocol code: M1095-PSA-303
Sponsor: MoonLake Immunotherapeutics AG (Pharmaceutical company). Phase: Therapeutic confirmatory (Phase III). Countries: Estonia (authorised, recruitment pending), Croatia (authorised, recruitment pending), Slovakia (authorised, recruitment pending), Lithuania (authorised, recruitment pending), Romania (authorised, recruitment pending), Hungary (authorised, recruitment pending), Germany (authorised, recruitment pending), France (authorised, recruitment pending), Latvia (authorised, recruitment pending), Poland (authorised, recruitment pending), Portugal (authorised, recruitment pending), Greece (authorised, recruitment pending), Czechia (authorised, recruitment pending), Bulgaria (authorised, recruitment pending), Finland (authorised, recruitment pending), Spain (authorised, recruitment pending).
Therapeutic area(s): Diseases [C] - Musculoskeletal Diseases [C05]
Gender: Female, Male. Age: 18-64 years, 65+ years. Enrolment: 948.
Status: Authorised, recruitment pending. Decision date: 2026-02-25. Results received: No. Last updated: 2026-03-09.
Decision dates by country: BG: 2026-03-06, HR: 2026-03-06, CZ: 2026-03-02, EE: 2026-03-04, FI: 2026-03-03, FR: 2026-02-26, DE: 2026-03-05, GR: 2026-02-25, LV: 2026-02-26, LT: 2026-02-26, PT: 2026-02-26, RO: 2026-03-09, ES: 2026-03-04, PL: 2026-03-07, SK: 2026-03-03, HU: 2026-02-26

Condition(s): psoriatic arthritis (PsA)
Product: Sonelokimab

Primary endpoint: Treatment-emergent adverse events (TEAEs), Serious adverse events (SAEs), TEAEs leading to study withdrawal, Adverse events of special interest (AESIs), Vital signs, and electrocardiogram (ECG) results, Abnormal laboratory parameters (hematology, clinical chemistry)

Source: https://euclinicaltrials.eu/ctis-public/view/2025-522471-28-00